EU clinical trial 2022-501142-30-00: Balloon + Oxytocin versus Oral Misoprostol to Induce labor in case of premature rupture of membranes (PROM) at term in nulliparous
Protocol code: PHRC N 2020 GALLOT
Sponsor: CHU Gabriel-Montpied (Hospital/Clinic/Other health care facility). Phase: Therapeutic use (Phase IV). Countries: France (ended).
Therapeutic area(s): Diseases [C] - Female Urogenital Diseases and Pregnancy Complications [C13]
Gender: Female. Age: 18-64 years. Enrolment: 520.
Status: Ended. Start date (EU): 2023-01-17. End date (EU): 2025-08-29. Decision date: 2022-09-15. Results received: No. Last updated: 2024-12-13.

Condition(s): pregnant women with premature rupture of membranes
Product: OXYTOCIN, CLINDAMYCIN, AMOXICILLIN, MISOPROSTOL, AMOXICILLIN SODIUM

Primary endpoint: Proportion of patients vaginally delivered <24h (binary endpoint Yes/No), Satisfaction of women concerning method of induction assessed between the second day after delivery (D2) and hospital discharge by the EXperience of Induction Tool (EXIT) validated in french language. Total score is not relevant29. So, three dimensions are explored and analyzed by EXIT scale: time taken to give birth, discomfort with IOL, experience of subsequent contractions.
Endpoint(s): Duration from rupture to beginning of induction, Duration between IOL and delivery, Duration of balloon exposure or misoprostol exposure, Total dose of misoprostol received, Bishop score on balloon removal, Rate of balloon in place at H12, Duration until full cervical dilatation, Rate of spontaneous vaginal delivery or instrumental delivery, Indication and rate of cesarean section, Rate of post-partum hemorrhage, Rate of fever during labour, Rate of patients experiencing episode(s) of uterine hyperstimulation during labour, Rate of endometritis, Duration of hospital stay, Birth weight, Apgar < 7 at 5 min (binary endpoint Yes/No), pH umbilical artery, Base defect and lactate (umbilical artery), at birth, Rate of transfer to intensive care unit or neonatology unit, Rate of maternal-fetal infection, Age at hospital discharge

Source: https://euclinicaltrials.eu/ctis-public/view/2022-501142-30-00